EU clinical trial 2026-525349-65-00: Open-label, safety, tolerability and proof of concept study to evaluate the use of ANXV (recombinant human Annexin A5 protein) in the treatment of patients with either Diabetic Retinopathy or recent onset Retinal Vein Occlusion
Protocol code: ANN-008
Sponsor: Annexin Pharmaceuticals AB (publ) (Pharmaceutical company). Phase: Therapeutic exploratory (Phase II). Countries: Germany (authorised, recruiting).
Therapeutic area(s): Diseases [C] - Eye Diseases [C11]
Gender: Female, Male. Age: 18-64 years, 65+ years. Enrolment: 12.
Status: Authorised, recruiting. Start date (EU): 2026-05-26. Decision date: 2026-04-02. Results received: No. Last updated: 2026-07-28.

Condition(s): Diabetic Retinopathy, Retinal Vein Occlusion

Primary endpoint: Incidence and severity of Treatment Emergent Adverse Events (TEAEs) and Serious Adverse Events (SAEs)., Incidence and titre of anti-drug antibodies (ADA) to ANXV pre- and post-administration.
Endpoint(s): Persistence and titre of ADA., OCT (CST, Macular Volume and ONL thickness, areas of oedema and DRIL), OCTA (FAZ, VD, Perfusion Density of the Vascular Complex layers on the macula, and vessel skeleton)., BCVA (ETDRS letters)., Contrast Sensitivity (letter log contrast sensitivity score)., Electroretinogram (ERG) (RETeval: DR Score, amplitude response and implicit time changes from baseline in Flicker ERG, change in PhNR)., Ultra-Wide Field Fundus Fluorescein Angiography (UWF-FFA) (DRSS score, RANP, vessel leakage, conversion from niRVO to iRVO, ISI)., Ultra-Wide Field Retinal Imaging (resolution of haemorrhages)., MMP (changes in Mean Sensitivity)., Rescue Treatment., The PK profile of ANXV as determined on the days of Treatment 1, Treatment 4 and Treatment 5 pre-infusion and at 15, 30, and 40 minutes and 1, 1.5, 2 and 4 hours after the start of the infusion., PK parameters after the first dose: AUClast, Cmax, Tmax, λz, T½, CL, Vz., PK parameters after the first dose: Dose proportionality, PK parameters after the fourth and fifth dose (or third dose for participants only receiving three doses): Area Under the Curve (AUC) during a dosage interval (tau) (AUCtau)., PK parameters after the fourth and fifth dose (or third dose for participants only receiving three doses): Cmax, Tmax, λz, T½, CL, Vz, Vss., PK parameters after the fourth and fifth dose (or third dose for participants only receiving three doses): Dose proportionality after multiple doses, based on AUC over the dose interval (AUCtau) and Cmax., PK parameters after the fourth and fifth dose (or third dose for participants only receiving three doses): Accumulation ratio., PK parameters after the fourth and fifth dose (or third dose for participants only receiving three doses): Minimum plasma concentrations of ANXV prior to dosing on the day of Treatment 4 and Treatment 5 (Cmin)., PK parameters after the fourth and fifth dose (or third dose for participants only receiving three doses): Mean plasma concentrations of ANXV on the day of Treatment 4 and Treatment 5 (Cmean).

Source: https://euclinicaltrials.eu/ctis-public/view/2026-525349-65-00